EU clinical trial 2024-512298-28-00: A Randomized, Controlled, Partially Masked, Phase 3b Study to Assess the Injection Burden, Efficacy, Safety, and Long-Term Preservation of Visual Acuity of Surabgene Lomparvovec (ABBV-RGX-314) in a Real-World Context in Subjects with Neovascular Age-Related Macular Degeneration (nAMD)
Protocol code: M24-528
Sponsor: AbbVie Deutschland GmbH & Co. KG (Pharmaceutical company). Phase: Phase III and phase IV (Integrated). Countries: Czechia (ongoing, recruiting), Portugal (authorised, recruiting), Hungary (ongoing, recruiting), Spain (ongoing, recruiting), Belgium (authorised, recruiting), Italy (ongoing, recruiting), Austria (ongoing, recruiting), France (ongoing, recruiting), Slovakia (authorised, recruitment pending), Croatia (ongoing, recruiting), Germany (ongoing, recruiting), Bulgaria (ongoing, recruiting), Greece (ongoing, recruiting).
Therapeutic area(s): Diseases [C] - Eye Diseases [C11]
Gender: Female, Male. Age: 18-64 years, 65+ years. Enrolment: 272.
Start date (EU): 2025-12-18. Decision date: 2025-12-02. Results received: No. Last updated: 2026-05-11.
Decision dates by country: AT: 2025-12-08, BE: 2025-12-03, BG: 2025-12-08, HR: 2025-12-08, CZ: 2025-12-04, GR: 2025-12-02, HU: 2025-12-08, PT: 2025-12-02, SK: 2025-12-02, ES: 2025-12-04, IT: 2025-12-05, DE: 2026-02-25, FR: 2025-12-04

Condition(s): Neovascular age-related macular degeneration
Product: Surabgene Lomparvovec (ABBV-RGX-314), Lucentis 10 mg/ml solution for injection in pre-filled syringe, Surabgene Lomparvovec (ABBV-RGX-314)

Primary endpoint: Annualized intravitreal anti-VEGF injection rate from Week 6 through Week 54.
Endpoint(s): Change from Baseline in BCVA at Year 3., Annualized intravitreal anti-VEGF injection rate from Week 6 through Year 3., Incidence and severity of ocular AEs in the study eye and contralateral eye, Change from Baseline in area of macular atrophy based on FAF at assessed time points in the study eye

Source: https://euclinicaltrials.eu/ctis-public/view/2024-512298-28-00